EU clinical trial 2023-505185-28-00: An early Phase 1b Study to assess how safe and effective is the treatment with drugs, called Mosunetuzumab or Glofitamab in Combination with drugs called, CC-220 and CC-99282 in Patients with B-Cell Non-Hodgkin Lymphoma.
Protocol code: CO43805
Sponsor: F. Hoffmann-La Roche AG (Pharmaceutical company). Phase: Human Pharmacology (Phase I)- Other. Countries: Italy (ongoing, recruiting), Spain (ongoing, recruiting).
Therapeutic area(s): Diseases [C] - Neoplasms [C04]
Gender: Female, Male. Age: 18-64 years, 65+ years. Enrolment: 52.
Status: Ongoing, recruiting. Start date (EU): 2026-04-23. Decision date: 2024-07-24. Results received: No. Last updated: 2026-03-17.
Decision dates by country: ES: 2024-07-24, IT: 2024-08-19

Condition(s): Non-Hodgkin Lymphoma

Source: https://euclinicaltrials.eu/ctis-public/view/2023-505185-28-00